EU clinical trial 2024-513965-38-01: A Randomized, Placebo-controlled, Double-blind, Multicenter Phase 3 Protocol to Assess the Efficacy and Safety of Nipocalimab in Adults with Moderate to Severe Sjögren's Disease (SjD)
Protocol code: 80202135SJS3001
Sponsor: Janssen Cilag International (Pharmaceutical company). Phase: Therapeutic confirmatory (Phase III). Countries: France (ongoing, recruitment ended), Bulgaria (ongoing, recruitment ended), Romania (ongoing, recruitment ended), Austria (ongoing, recruitment ended), Italy (ongoing, recruitment ended), Poland (ongoing, recruitment ended), Hungary (ongoing, recruitment ended), Denmark (ongoing, recruitment ended), Spain (ongoing, recruitment ended), Germany (ongoing, recruitment ended), Portugal (ongoing, recruitment ended), Netherlands (ended), Norway (ongoing, recruitment ended), Czechia (ongoing, recruitment ended), Slovakia (ended).
Therapeutic area(s): Diseases [C] - Immune System Diseases [C20]
Gender: Female, Male. Age: 18-64 years, 65+ years. Enrolment: 309.
Start date (EU): 2025-06-16. Decision date: 2025-06-05. Results received: No. Last updated: 2026-06-08.
Decision dates by country: SK: 2026-01-20, RO: 2025-06-30, PT: 2025-06-11, BG: 2025-06-17, NL: 2026-01-19, DE: 2025-06-13, FR: 2025-07-07, AT: 2025-06-05, HU: 2025-07-03, ES: 2025-06-06, PL: 2025-06-23, DK: 2025-06-11, CZ: 2026-01-14, IT: 2025-06-19, NO: 2026-01-19

Condition(s): Sjögren's Disease
Product: Placebo subcutaneous without Nipocalimab, JNJ-80202135

Primary endpoint: Change from Baseline in Clinical European League Against Rheumatism Sjogren’s Syndrome Disease Activity Index (ClinESSDAI) Score at Week 48.

Source: https://euclinicaltrials.eu/ctis-public/view/2024-513965-38-01